EU clinical trial 2024-512399-37-00: A Phase 3, Multicenter, Open-Label Extension Study of Zilucoplan in Subjects with Generalized Myasthenia Gravis
Protocol code: RA101495-02.302
Sponsor: UCB Biopharma (Pharmaceutical company). Phase: Therapeutic confirmatory (Phase III). Countries: Norway (ongoing, recruitment ended), Poland (ongoing, recruitment ended), Spain (ended), Italy (ended).
Therapeutic area(s): Diseases [C] - Immune System Diseases [C20]
Gender: Female, Male. Age: 18-64 years, 65+ years. Enrolment: 37.
Start date (EU): 2020-12-29. Decision date: 2024-07-25. Results received: No. Last updated: 2025-12-03.
Decision dates by country: ES: 2024-07-30, IT: 2024-08-05, NO: 2024-07-25, PL: 2024-07-29

Condition(s): Generalized Myasthenia Gravis
Product: Zilbrysq 32.4 mg solution for injection in pre-filled syringe, Zilbrysq 23 mg solution for injection in pre-filled syringe, Zilbrysq 16.6 mg solution for injection in pre-filled syringe

Primary endpoint: • Incidence of TEAEs
Endpoint(s): • CFB to Week E12 in the Myasthenia Gravis-Activities of Daily Living (MG-ADL) Score, • CFB to Week E12 in the Quantitative Myasthenia Gravis (QMG) Score, • CFB to Week E12 in the Myasthenia Gravis Composite (MGC) Score, • CFB to Week E12 in the Myasthenia Gravis – Quality of Life revised (MG-QOL15r) Score

Source: https://euclinicaltrials.eu/ctis-public/view/2024-512399-37-00